EU clinical trial 2024-511528-15-00: Comparative analysis of the effectiveness and security of the blockade Erectus Spinae Plane Lumbar (ESP-L) versus the absence of locoregional block in hip surgery
Sponsor: Asociacion Gallega De Anestesiologia Reanimacion Y Dolor (Patient organisation/association). Phase: Therapeutic use (Phase IV). Countries: Spain (ended).
Therapeutic area(s): Analytical, Diagnostic and Therapeutic Techniques and Equipment [E] - Anesthesia and Analgesia [E03]
Gender: Female, Male. Age: 18-64 years, 65+ years. Enrolment: 170.
Status: Ended. Start date (EU): 2024-06-02. End date (EU): 2025-05-08. Decision date: 2024-05-27. Results received: No. Last updated: 2024-05-27.

Condition(s): Hip fracture
Product: Levobupivacaina Kabi 2,5 mg/ml soluzione iniettabile/per infusione

Primary endpoint: To compare the analgesic efficacy and safety of lumbar ESP block versus the absence of blockade in the postoperative period of hip and proximal femur surgery through the VAS scale with pain reduction of at least 1 point after two hours postoperative.
Endpoint(s): - Compare postoperative analgesic needs after performing the block ESP-L versus control group of patients undergoing hip or femur surgery proximal - Compare postoperative opioid consumption in the two groups. - Assess and compare the technical ease of the intervention (ESP-L block) - Compare the side effects in the two lines of treatment - Assess the level of patient satisfaction

Source: https://euclinicaltrials.eu/ctis-public/view/2024-511528-15-00